EU clinical trial 2023-508128-37-00: Long Term Follow-Up of Patients Exposed to Lentiviral-Based CAR T-CellTherapy
Protocol code: CCTL019A2205B
Sponsor: Novartis Pharma Services AG (Pharmaceutical company). Phase: Therapeutic confirmatory (Phase III). Countries: Sweden (authorised, recruitment pending), France (ongoing, recruiting), Finland (ongoing, recruiting), Netherlands (ongoing, recruiting), Austria (ongoing, recruiting), Norway (ongoing, recruiting), Germany (ongoing, recruiting), Belgium (ongoing, recruiting), Denmark (ongoing, recruiting), Spain (ongoing, recruiting), Italy (ongoing, recruiting), Greece (ongoing, recruiting).
Therapeutic area(s): Diseases [C] - Immune System Diseases [C20]; Diseases [C] - Hemic and Lymphatic Diseases [C15]
Gender: Female, Male. Age: 0-17 years, 18-64 years, 65+ years. Enrolment: 222.
Start date (EU): 2017-07-19. Decision date: 2024-02-08. Results received: No. Last updated: 2026-04-20.
Decision dates by country: DE: 2024-02-09, FR: 2024-02-08, GR: 2025-03-11, NL: 2024-02-08, DK: 2024-02-08, SE: 2024-02-08, NO: 2024-02-08, FI: 2024-02-08, ES: 2024-02-12, AT: 2024-03-14, IT: 2024-02-23, BE: 2024-02-09

Condition(s): All patients who have been treated with Novartis or Penn CAR T-cell therapy for any indication
Product: YTB323, TISAGENLECLEUCEL, PHE885

Primary endpoint: Proportion of patients with events in each of the following categories: For participants treated for non-hematology/non-oncology indications: New primary malignancies•For participants with hematology/oncology indications: New secondary malignancies•New serious infections•New incidence of serious neurologic disorder•New incidence or exacerbation of a prior rheumatologic or other autoimmune disorder•New incidence of a hematologic disorder•Other adverse events considered related to CAR T-cell thera
Endpoint(s): Proportion of patients with detectable CAR transgene levels in peripheral blood by qPCR at pre-specified time points, Proportion of patients with detectable RCL by VSV-G qPCR in peripheral blood at pre-specified time points, • Proportion of patients who relapse or progress among patients who had not relapsed or progressed at study entry/re-entry • Incidence of death Note: For non-hematology/non-oncology patients, though there will be no formal assessments for efficacy, data on disease indication management will be captured in the Concomitant Medication CRF (e.g., rescue medication including immunosuppressive medications)., B and T lymphocyte counts, Height and weight, Tanner staging, menstruation status The pregnancy status for female patients will be captured in the CRF. For female partners of male patients if female partners provide consent, pregnancy outcome and data on live births for infants at birth, 3 months and 1 year of age is captured in Novartis safety forms.

Source: https://euclinicaltrials.eu/ctis-public/view/2023-508128-37-00